EU clinical trial 2024-511585-36-00: Personalized tacrolimus treatment for pediatric kidney transplant recipients by using a dosing algorithm and a once-daily tacrolimus formulation
Sponsor: Erasmus Universitair Medisch Centrum Rotterdam (Erasmus MC) (Hospital/Clinic/Other health care facility). Phase: Therapeutic use (Phase IV). Countries: Netherlands (ended).
Therapeutic area(s): Not possible to specify
Gender: Female, Male. Age: 0-17 years. Enrolment: 28.
Status: Ended. Start date (EU): 2024-06-28. End date (EU): 2026-07-22. Decision date: 2024-06-28. Results received: No. Last updated: 2024-06-28.

Condition(s): pediatric kidney transplant recipients
Product: PROGRAF 1 mg capsule, Modigraf 0.2 mg granules for oral suspension, Envarsus 0.75 mg prolonged-release tablets, PROGRAF 0,5 mg capsule, Envarsus 4 mg prolonged-release tablets, Envarsus 1 mg prolonged-release tablets, PROGRAF 5 mg capsule, Modigraf 1 mg granules for oral suspension

Primary endpoint: The percentage of children within the target C0 range of tacrolimus (10-15 ng/mL) on day 3 after kidney transplantation following algorithm-based dosing

Source: https://euclinicaltrials.eu/ctis-public/view/2024-511585-36-00